EU clinical trial 2023-505212-38-00: A Study to Evaluate the Safety, Pharmacokinetics, and Activity of XmAb24306 in Combination with Cevostamab in Patients with Relapsed/Refractory Multiple Myeloma
Protocol code: GO43980
Sponsor: Genentech Inc. (Pharmaceutical company). Phase: Human Pharmacology (Phase I)- Other. Countries: Denmark (ended), Norway (ongoing, recruitment ended), Greece (ongoing, recruitment ended), Spain (ended).
Therapeutic area(s): Diseases [C] - Neoplasms [C04]
Gender: Female, Male. Age: 18-64 years, 65+ years. Enrolment: 43.
Start date (EU): 2022-11-16. Decision date: 2024-07-02. Results received: No. Last updated: 2026-03-03.
Decision dates by country: DK: 2024-07-04, GR: 2024-08-12, ES: 2024-07-05, NO: 2024-07-02

Condition(s): Relapsed/Refractory Multiple Myeloma

Source: https://euclinicaltrials.eu/ctis-public/view/2023-505212-38-00